EU clinical trial 2025-523266-24-00: “A phase 2 multi-center study investigating the efficacy, safety and tolerability of pioglitazone in adult participants with non-segmental vitiligo”
Protocol code: 2025-523266-24-00
Sponsor: I.F.O. Istituti Fisioterapici Ospitalieri (Hospital/Clinic/Other health care facility). Phase: Therapeutic exploratory (Phase II). Countries: Italy (authorised, recruitment pending).
Therapeutic area(s): Diseases [C] - Skin and Connective Tissue Diseases [C17]
Gender: Female, Male. Age: 18-64 years. Enrolment: 60.
Status: Authorised, recruitment pending. Decision date: 2025-11-26. Results received: No. Last updated: 2025-11-26.

Condition(s): Vitiligo
Product: Pioglitazone Mylan 15 mg compresse

Primary endpoint: - Proportion of subjects achieving F-VASI50 (defined as at least 50% improvement in F-VASI from baseline) at Week 16

Source: https://euclinicaltrials.eu/ctis-public/view/2025-523266-24-00